EU clinical trial 2025-522193-37-00: Evaluation of the efficacy of corticosteroids in septic arthritis in adults: Randomized double-blind controlled trial [CORSAR]
Protocol code: APHP240792
Sponsor: Assistance Publique Hopitaux De Paris (Hospital/Clinic/Other health care facility). Phase: Therapeutic confirmatory (Phase III). Countries: France (ongoing, recruiting).
Therapeutic area(s): Diseases [C] - Bacterial Infections and Mycoses [C01]
Gender: Female, Male. Age: 18-64 years, 65+ years. Enrolment: 200.
Status: Ongoing, recruiting. Start date (EU): 2026-06-09. Decision date: 2026-02-10. Results received: No. Last updated: 2026-02-10.

Condition(s): Septic arthritis
Product: Placebo de PREDNISONE ARROW 20 mg, PREDNISONE ARROW 20 mg, comprimé sécable

Primary endpoint: Functional assessment score at week 24. This outcome will be assessed using the total WOMAC score (Western Ontario and McMaster Universities Osteoarthritis Index) for lower limb involvement (hip, knee, or ankle joints). For upper limb involvement (shoulder, elbow, or wrist joints), the QuickDASH score (Disabilities of the Arm, Shoulder and Hand) will be used. The WOMAC or QuickDASH score will be standardized and reported on a scale ranging from 0 to 100 points.
Endpoint(s): Joint flexion and extension measured at weeks 1, 6, and 24 using a goniometer. Presence of flexion contracture (defined as incomplete extension) at 3 months, assessed only for septic arthritis of the hip and knee., Any complication assessed by radiological examination of the joint at week 24., Number of surgical interventions between randomization and week 24., Duration of antibiotic therapy., Length of hospital stay, Pain assessed by Visual Analog Scale (VAS) at weeks 1, 6, and 24., Overall mortality., Biological inflammatory markers measured at weeks 1, 6, and 24., Patient self-assessment of recovery on a 0 to 5 scale (0 = no improvement, 5 = full recovery) at weeks 1, 6, and 24., Quality of life assessed by the EQ-5D-5L questionnaire at week 24., Number of days on painkillers, overall and according to WHO level (I, II, III), between W1 and W6, All adverse effects and side effects, particularly glycemic control and neuropsychiatric effects, monitored through patient self-surveillance.

Source: https://euclinicaltrials.eu/ctis-public/view/2025-522193-37-00